EU clinical trial 2023-506390-35-00: A Phase 1 Dose Escalation and Cohort Expansion Study of TSR-042, an anti-PD-1 Monoclonal Antibody, in Patients with Advanced Solid Tumors
Protocol code: 4010-01-001
Sponsor: Tesaro Inc. (Pharmaceutical company). Phase: Human Pharmacology (Phase I)- First administration to humans. Countries: Poland (ongoing, recruitment ended), Spain (ongoing, recruitment ended), Denmark (ongoing, recruitment ended), Czechia (ongoing, recruitment ended), France (ongoing, recruitment ended), Italy (ongoing, recruitment ended).
Therapeutic area(s): Diseases [C] - Neoplasms [C04]
Gender: Female, Male. Age: 18-64 years, 65+ years. Enrolment: 520.
Status: Ongoing, recruitment ended. Start date (EU): 2017-04-19. Decision date: 2024-03-18. Results received: No. Last updated: 2026-07-22.
Decision dates by country: CZ: 2024-03-18, IT: 2024-03-18, PL: 2024-04-15, DK: 2024-03-18, FR: 2024-03-26, ES: 2024-03-20

Condition(s): Patients with Advanced Solid Tumors

Source: https://euclinicaltrials.eu/ctis-public/view/2023-506390-35-00